EU clinical trial 2024-511775-15-00: A parallel-group treatment, Phase 2a, multicenter, randomized, double-blind, placebo-controlled umbrella study to evaluate the efficacy and safety of frexalimab, brivekimig and rilzabrutinib in participants aged 16 to 75 years with primary focal segmental glomerulosclerosis (FSGS) or minimal change disease (MCD)
Protocol code: ACT18064
Sponsor: Sanofi-Aventis Recherche & Developpement (Pharmaceutical company). Phase: Therapeutic exploratory (Phase II). Countries: Hungary (ongoing, recruiting), Portugal (ongoing, recruiting), Italy (ongoing, recruiting), France (authorised, recruitment pending), Germany (ongoing, recruiting), Spain (ongoing, recruiting), Netherlands (ongoing, recruiting), Greece (ongoing, recruiting), Poland (ongoing, recruiting), Czechia (ongoing, recruiting), Slovakia (ongoing, recruiting).
Therapeutic area(s): Diseases [C] - Immune System Diseases [C20]
Gender: Female, Male. Age: 18-64 years, 65+ years. Enrolment: 40.
Start date (EU): 2025-01-17. Decision date: 2024-12-09. Results received: No. Last updated: 2026-07-07.
Decision dates by country: CZ: 2024-12-11, FR: 2024-12-11, DE: 2024-12-11, GR: 2024-12-09, IT: 2024-12-13, NL: 2024-12-12, PL: 2025-12-15, SK: 2024-12-09, ES: 2024-12-16, PT: 2024-12-11, HU: 2024-12-13

Condition(s): Immune system diseases

Primary endpoint: Percent reduction in urine protein to creatinine ratio (UPCR)
Endpoint(s): Percentage of participants achieving FSGS partial remission endpoint, Percentage of participants achieving CR, Incidence of treatment-emergent adverse events, treatment-emergent serious adverse events (SAEs), treatment-emergent adverse events of special interest (AESIs) and IMP discontinuation due to TEAEs during the study, Plasma concentrations of frexalimab and rilzabrutinib and serum concentrations of SAR442970, Occurrence of anti-drug antibodies (ADAs) against frexalimab and SAR442970

Source: https://euclinicaltrials.eu/ctis-public/view/2024-511775-15-00